EU clinical trial 2025-523491-23-00: Efficacy of asciminib in chronic phase CML patients with T315l mutations
Protocol code: ESTIMATION
Sponsor: Friedrich-Schiller-Universitaet Jena (Educational Institution). Phase: Therapeutic exploratory (Phase II). Countries: Germany (authorised, recruitment pending).
Therapeutic area(s): Diseases [C] - Neoplasms [C04]
Gender: Female, Male. Age: 18-64 years, 65+ years. Enrolment: 50.
Status: Authorised, recruitment pending. Decision date: 2026-06-23. Results received: No. Last updated: 2026-07-30.

Condition(s): Chronic Myeloid Leukemia
Product: Scemblix 40 mg film-coated tablets, Asciminib

Primary endpoint: rate of MR2 at 12 months measured by BCR::ABL1 via PCR
Endpoint(s): Reduction of the size of the T315I positive BCR::ABL1 clone by NGS measurement, Rate of molecular response assessed by BCR-ABLIS monitoring at and by 6, 18, 24 months, Progression-free survival, probabilities of CML-related death, overall survival at and by end of study, Quality of life at enrolment and months 3, 6, 9, 12, 18, and 24 after start with asciminib

Source: https://euclinicaltrials.eu/ctis-public/view/2025-523491-23-00